EU clinical trial 2024-516164-28-00: A double-blind, placebo-controlled, parallel-group study to evaluate the safety and efficacy of briquilimab in participants with allergic asthma.
Protocol code: JSP-CP-012
Sponsor: Jasper Therapeutics Inc. (Pharmaceutical company). Phase: Human Pharmacology (Phase I)- Other. Countries: Germany (ended).
Therapeutic area(s): Diseases [C] - Respiratory Tract Diseases [C08]
Gender: Female, Male. Age: 18-64 years, 65+ years. Enrolment: 8.
Status: Ended. End date (EU): 2024-12-05. Decision date: 2024-10-24. Results received: No. Last updated: 2024-11-07.

Condition(s): allergic asthma

Source: https://euclinicaltrials.eu/ctis-public/view/2024-516164-28-00